EU clinical trial 2024-519048-33-00: Risk-adapted adjuvant chemotherapy guided by the tumour stage for operated pancreatic adenocarcinoma following neoadjuvant chemotherapy with FOLFIRINOX FRENCH26 – PRODIGE93 - PANACHE02 Trial
Protocol code: 2021/0377/HP
Sponsor: Centre Hospitalier Universitaire Rouen (Hospital/Clinic/Other health care facility). Phase: Phase II and Phase III (Integrated). Countries: France (ongoing, recruiting).
Therapeutic area(s): Diseases [C] - Neoplasms [C04]
Gender: Female, Male. Age: 18-64 years, 65+ years. Enrolment: 390.
Status: Ongoing, recruiting. Start date (EU): 2025-11-25. Decision date: 2025-05-28. Results received: No. Last updated: 2025-05-28.

Condition(s): resected pancreatic adenocarcinoma
Product: ELVORINE 100 mg/10 mL, solution injectable, Apexelsin 5 mg/ml powder for dispersion for infusion., GEMCITABINE ACCORD 100 mg/ml, solution à diluer pour perfusion, Irinotecan Accord 20 mg/ml Solution à diluer pour perfusion, FLUOROURACILE ACCORD 50 mg/ml, solution à diluer pour perfusion, OXALIPLATINE ACCORD 5 mg/ml, solution à diluer pour perfusion

Primary endpoint: Phase 2: The primary efficacy endpoint is the Disease Free Survival (DFS), defined as the time from randomization to locoregional recurrence, occurrence of distant metastases or second pancreatic cancer, or death (all causes) whichever occurred first. Patients free of events will be censored at the date of the last disease evaluation either during study treatment period or during follow-up period (1,53)., Phase 3: The primary efficacy endpoint is the Overall Survival (OS), defined as the time from randomization to the death from any cause. Alive patient will be censored at last date known to be alive either during study treatment period or during follow-up period
Endpoint(s): • Incidence and grade for Adverse events (AEs), drug related AEs, drug related AE leading to dose reduction or discontinuation during treatment, SAE and SUSAR, according to NCI-CTCAE V5.0., • OS (phase 2), • DFS (Phase 3), • Time to metastatic recurrence defined as the time from randomization to occurrence of distant metastases. Patients with locoregional recurrence, second pancreatic cancer, or death (all causes) without metastatic recurrence will be censored at time of event whichever occurred first. Patients free of locoregional recurrence, second pancreatic cancer, or death (all causes) without metastatic recurrence will be censored at the date of the last disease evaluation, • Early recurrence < 6 months after surgical randomization, • Health related quality of life EORTC QLQ-C30 and QLQ-PAN26 questionnaires, • Tumour response and clinico-pathological criteria (size (T stage); margins (R0/R1 status); lymph node invasion (N stage)), DFS and OS

Source: https://euclinicaltrials.eu/ctis-public/view/2024-519048-33-00